EU clinical trial 2022-501504-95-00: A Randomized Trial of Trastuzumab Deruxtecan and Biology-Driven Selection of Neoadjuvant Treatment for HER2-positive Breast Cancer: ARIADNE
Protocol code: ARIADNE
Sponsor: Karolinska University Hospital (Hospital/Clinic/Other health care facility). Phase: Therapeutic exploratory (Phase II). Countries: Sweden (ongoing, recruiting), Norway (ongoing, recruiting), Belgium (authorised, recruitment pending).
Therapeutic area(s): Diseases [C] - Neoplasms [C04]
Gender: Female, Male. Age: 18-64 years, 65+ years. Enrolment: 402.
Start date (EU): 2023-06-23. Decision date: 2023-04-19. Results received: No. Last updated: 2026-03-31.
Decision dates by country: NO: 2024-04-09, SE: 2023-04-19, BE: 2025-08-18

Condition(s): Non-metastatic HER2-positive Breast Cancer
Product: Zarzio 48 MU/0.5 ml solution for injection or infusion in pre-filled syringe, Carboplatin Accord 10 mg/ml koncentrat till infusionsvätska, lösning, Ondansetron Bluefish 8 mg munsönderfallande tabletter, Goserelin UAB Boston Biopharma LT 3.6 mg implant, in a pre-filled syringe, Paclitaxel Actavis 6 mg/ml koncentrat till infusionsvätska, lösning., Kisqali 200 mg film‑coated tablets, Enhertu 100 mg powder for concentrate for solution for infusion, Phesgo 600 mg/600 mg solution for injection, Palonosetron Fresenius Kabi 250 mikrogram injektionsvätska, lösning, Dexamethasone Orifarm 4 mg tabletter, Letrozole Bluefish 2,5 mg filmdragerade tabletter, Metoclopramide ”Orifarm”, tabletter, Olanzapine 5mg Film-coated Tablets, Docetaxel Accord 80 mg/4 ml concentrate for solution for infusion, Perjeta 420 mg concentrate for solution for infusion, Phesgo 1200 mg/600 mg solution for injection, Neulasta 6 mg solution for injection, Sendoxan pulver till injektionsvätska, lösning, Herceptin 150 mg powder for concentrate for solution for infusion, EMEND 125 mg+80 mg hard capsules, Epirubicin Accord 2 mg/ml injektions-/infusionsvätska, lösning, Betapred 0,5 mg tablett

Primary endpoint: Locally assessed rate of pCR at the molecularly HER2-enriched population, defined as ypT0/Tis, ypN0, as determined at the surgical specimen by a pathologist blinded to treatment assignment (intention-to-treat analysis).
Endpoint(s): Locally assessed rate of pCR, defined as ypT0/Tis, ypN0, at the two patient groups of the initial randomization of TCHP versus T-DXd, regardless of administered therapy after cycle 3, Locally assessed rate of pCR at ER-positive and luminal subgroup, Locally assessed rate of pCR at ER-negative and luminal subgroup, at the basal-like subgroup and the normal-like subgroup, Locally assessed rate of pCR at all molecular subgroups in the evaluable population, Rates of radiologic complete response after three courses of either standard therapy or T-DXd, Overall survival (OS), defined as time from randomization to death by any cause, for each molecular group, including the comparison of TCHP versus T-DXd -> THP in HER2-enriched patients, and at the two patient groups of the initial randomization of TCHP versus T-DXd, Distant relapse-free survival (DRFS), defined as time from randomization to distant metastases or death by any cause, for each molecular group, including the comparison of TCHP versus T-DXd -> THP in HER2-enriched patients, and at the two patient groups of the initial randomization of TCHP versus T-DXd, Event-free survival (EFS), defined as time from randomization to disease progression, breast cancer relapse, contralateral breast cancer, other malignant neoplasms, or death by any cause, for each molecular group, including the comparison of TCHP versus T-DXd -> THP in HER2-enriched patients, and at the two patient groups of the initial randomization of TCHP versus T-DXd, Rates of complete radiologic response, for each molecular group, including the comparison of TCHP versus T-DXd -> THP in HER2-enriched patients, and at the two patient groups of the initial randomization of TCHP versus T-DXd, Pathologic response according to Residual Cancer Burden Class, as described in 1, 2, for each molecular group, including the comparison of TCHP versus T-DXd -> THP in HER2-enriched patients, and at the two patient groups of the initial randomization of TCHP versus T-DXd, Rate of breast conserving surgery, for each molecular group, including the comparison of TCHP versus T-DXd in HER2-enriched patients, and at the two patient groups of the initial randomization of TCHP versus T-DXd, Rate of de-escalation of breast surgery (conversion from mastectomy to breast conserving surgery or de-escalation of complexity from an oncoplastic breast-conserving procedure to simple wide local excisions) for each molecular group, including the comparison of TCHP versus T-DXd -> THP in HER2-enriched patients, and at the two patient groups of the initial randomization of TCHP versus T-DXd, Rate of Sentinel Lymph Node Dissection (SLND), for each molecular group, including the comparison of TCHP versus T-DXd -> THP in HER2-enriched patients, and at the two patient groups of the initial randomization of TCHP versus T-DXd, Rate of de-escalation of axillary surgery (conversion from axillary lymph node dissection to either targeted axillary dissection or sentinel lymph node dissection) for each molecular group, including the comparison of TCHP versus T-DXd in HER2-enriched patients, and at the two patient groups of the initial randomization of TCHP versus T-DXd., Rate of Sentinel Lymph Node detection, Targeted Axillary Dissection success and false-negative rates of these procedures in initially node-positive patients for each molecular group, including the comparison of TCHP versus T-DXd in HER2-enriched patients, and at the two patient groups of the initial randomization of TCHP versus T-DXd, Frequency and grade of adverse events (AE) (according to NCI CTCAE v. 5.0, see https://ctep.cancer.gov/protocolDevelopment/electronic_applications/docs/CTCAE_v5_Quick_Reference_5x7.pdf) and rate of discontinuation due to toxicity, PRO endpoints including health related quality of life scores [European Organization for Research and Treatment of Cancer Quality of Life Instrument (EORTC QLQ-C30); European Organization for Research and Treatment of Cancer Breast Cancer Module (EORTC QLQ-BR23)]., Exploratory analyses of clinicopathologic characteristics as predictors for response, Discovery of biomarkers of response/resistance to administered neoadjuvant therapy at the protein, RNA and DNA levels in both tumor tissue and blood/plasma, as described in detail in protocol section 9.

Source: https://euclinicaltrials.eu/ctis-public/view/2022-501504-95-00